EU clinical trial 2023-507850-33-00: A Phase 3, Open-label, Single Arm, Multicenter Study of Ravulizumab in Addition to Best Supportive Care in Pediatric Participants (from 1 month to <18 years of age) with Thrombotic Microangiopathy (TMA) after Hematopoietic Stem Cell Transplantation (HSCT)
Protocol code: ALXN1210-TMA-314
Sponsor: Alexion Pharmaceuticals Inc. (Pharmaceutical company). Phase: Therapeutic confirmatory (Phase III). Countries: Spain (ended), France (ended), Germany (ended), Italy (ended).
Therapeutic area(s): Diseases [C] - Hemic and Lymphatic Diseases [C15]
Gender: Female, Male. Age: 0-17 years. Enrolment: 14.
Status: Ended. Start date (EU): 2021-02-05. End date (EU): 2025-05-27. End date: 2025-05-27. Decision date: 2023-11-17. Results received: Yes. Last updated: 2025-03-19.
Decision dates by country: FR: 2023-11-20, DE: 2023-11-22, ES: 2023-11-17, IT: 2024-01-09

Condition(s): Hematopoietic stem cell transplant-associated thrombotic microangiopathy(HSCT- TMA)
Product: Ultomiris 300 mg/30 mL concentrate for solution for infusion

Primary endpoint: TMA response
Endpoint(s): Time to TMA response, Change from baseline in TMA-associated organ dysfunction in renal system, cardiovascular system, pulmonary system, CNS, and GI system at 6 months and 1 year, TMA relapse during the follow-up period, Overall survival, Non-relapse mortality, Platelet response, Hematologic response

Source: https://euclinicaltrials.eu/ctis-public/view/2023-507850-33-00